EU clinical trial 2024-519605-36-00: A Phase 2, Randomized, Double-Blind, Placebo- and Active-Comparator-Controlled Clinical Study of V940 (mRNA-4157) Plus Pembrolizumab Versus Placebo Plus Pembrolizumab in Participants in First-Line Metastatic Melanoma (INTerpath-012)
Protocol code: V940-012
Sponsor: Merck Sharp & Dohme LLC (Pharmaceutical company). Phase: Therapeutic exploratory (Phase II). Countries: Greece (ongoing, recruiting), Germany (ongoing, recruiting), Poland (ongoing, recruiting), Spain (ongoing, recruiting), France (ongoing, recruiting), Italy (ongoing, recruiting), Portugal (ongoing, recruiting).
Therapeutic area(s): Diseases [C] - Neoplasms [C04]
Gender: Female, Male. Age: 18-64 years, 65+ years. Enrolment: 97.
Status: Ongoing, recruiting. Start date (EU): 2025-08-08. Decision date: 2025-07-30. Results received: No. Last updated: 2026-08-05.
Decision dates by country: IT: 2025-07-30, ES: 2025-07-31, DE: 2025-08-04, PL: 2025-08-04, PT: 2025-07-31, FR: 2025-07-30, GR: 2025-07-31

Condition(s): Melanoma
Product: mRNA-4157, KEYTRUDA 25 mg/mL concentrate for solution for infusion, Placebo to V940

Primary endpoint: Progression-free survival (PFS)
Endpoint(s): Objective Response (OR), Duration of Response (DOR), Overall Survival (OS), Number of participants with ≥1 adverse event (AE), Number of participants discontinuing from study therapy due to AE

Source: https://euclinicaltrials.eu/ctis-public/view/2024-519605-36-00